EU clinical trial 2025-523469-79-00: A Study to Investigate ARV-027 in Healthy Male Participants and Participants with Spinal and Bulbar Muscular Atrophy
Protocol code: ARV-027-101
Sponsor: Arvinas Operations Inc. (Pharmaceutical company). Phase: Human Pharmacology (Phase I)- First administration to humans. Countries: Netherlands (ongoing, recruiting).
Therapeutic area(s): Diseases [C] - Nervous System Diseases [C10]
Gender: Male. Age: 18-64 years, 65+ years. Enrolment: 106.
Status: Ongoing, recruiting. Start date (EU): 2026-01-16. Decision date: 2025-12-24. Results received: No. Last updated: 2026-07-09.

Condition(s): Spinal and Bulbar Muscular Atrophy

Source: https://euclinicaltrials.eu/ctis-public/view/2025-523469-79-00